EU clinical trial 2024-515590-10-00: Impact of Exercise and Mediterranean diet vs Aspirin on live-birth rate and cardiovascular programming in In Vitro Fertilization (MEDITATE-IVF): a Randomized Study.
Protocol code: IIBSP-EDA-2020-18
Sponsor: Fundacio Institut De Recerca De L'Hospital De La Santa Creu I Sant Pau (Hospital/Clinic/Other health care facility). Phase: Therapeutic confirmatory (Phase III). Countries: Spain (ongoing, recruiting).
Therapeutic area(s): Diseases [C] - Female Urogenital Diseases and Pregnancy Complications [C13]
Gender: Female. Age: 18-64 years. Enrolment: 150.
Status: Ongoing, recruiting. Start date (EU): 2021-09-16. Decision date: 2024-07-15. Results received: No. Last updated: 2024-11-15.

Condition(s): Women infertility
Product: TROMALYT 150 mg cápsulas duras de liberación prolongada

Primary endpoint: Cumulative live-birth rate: defined as the number of deliveries that result in a live born neonate, expressed per 100 embryo transfers.

Source: https://euclinicaltrials.eu/ctis-public/view/2024-515590-10-00